EU clinical trial 2024-517106-28-00: COBRA - Chemoablation for Low Grade Bladder Cancer: A single arm, prospective, open-label, investigator-initiated Phase 2 study
Sponsor: Medical University Of Vienna (Educational Institution). Phase: Therapeutic exploratory (Phase II). Countries: Austria (ongoing, recruiting).
Therapeutic area(s): Diseases [C] - Neoplasms [C04]
Gender: Female, Male. Age: 18-64 years, 65+ years. Enrolment: 47.
Status: Ongoing, recruiting. Start date (EU): 2023-12-27. Decision date: 2024-10-30. Results received: No. Last updated: 2024-10-30.

Condition(s): Bladder cancer
Product: GEMSOL

Primary endpoint: Clinical complete response (cCR, absence of the macroscopic tumor after chemoablation)
Endpoint(s): Pathological complete response (pCR), Overall response (cCR + pCR), Treatment-related adverse events evaluated using the National Cancer Institute’s Common Terminology Criteria for Adverse Events (version 5.0), Rate of treatment discontinuation (at least 5 from 6 instillations within 8 weeks), Health-related quality of life

Source: https://euclinicaltrials.eu/ctis-public/view/2024-517106-28-00